EU clinical trial 2024-511071-16-00: A Phase 1, Multicentre, Open-label, Dose-escalation and Cohort Expansion Study of Niraparib and Dostarlimab in Paediatric Patients with Recurrent or Refractory Solid Tumours
Protocol code: 213406
Sponsor: Glaxosmithkline Research & Development Limited (Pharmaceutical company). Phase: Human Pharmacology (Phase I)- Other. Countries: Spain (ended), Germany (ended), Czechia (ended), Hungary (ended), France (ended).
Therapeutic area(s): Diseases [C] - Neoplasms [C04]
Gender: Female, Male. Age: 0-17 years. Enrolment: 121.
Status: Ended. Start date (EU): 2022-02-10. End date (EU): 2025-03-04. End date: 2025-04-23. Decision date: 2024-04-26. Results received: Yes. Last updated: 2024-10-28.
Decision dates by country: HU: 2024-04-30, DE: 2024-05-02, CZ: 2024-04-30, ES: 2024-04-26, FR: 2024-05-02

Condition(s): Solid Tumours
Product: Zejula 100 mg film-coated tablets, Zejula 100 mg film-coated tablets, JEMPERLI 500 mg concentrate for solution for infusion

Primary endpoint: Part 1A and 1B: Assess the incidence of DLTs by study part and cohort for the DLT-evaluable population to establish the RP2D of the combination of niraparib (both tablet in Part 1a and TfOS in Part 1b) and dostarlimab. Part 2: Please refer to the separate cohort-specific supplements for this information.
Endpoint(s): • ORR based on Investigator assessment is defined as the proportion of participants with a BOR of confirmed CR or PR as determined by the Investigator using RECIST v1.1 or INRC (for participants with neuroblastoma only)., • DOR is defined as the time from first documentation of response (CR or PR) until the time of first documented PD by RECIST v1.1 or INRC (for participants with neuroblastoma only) based on Investigator assessment or death (whichever occurs first)., Part 1: Please refer to main study protocol for further Endpoints Part 2: Please refer to the separate cohort-specific supplements for this information.

Source: https://euclinicaltrials.eu/ctis-public/view/2024-511071-16-00